EU clinical trial 2023-505705-17-00: THE EFFECT OF ABIRATERONE ON THE METABOLISM OF OXYCODONE (ENABLE study)
Sponsor: Deventer Ziekenhuis (Hospital/Clinic/Other health care facility). Phase: Therapeutic use (Phase IV). Countries: Netherlands (ongoing, recruiting).
Therapeutic area(s): Diseases [C] - Neoplasms [C04]; Diseases [C] - Male Urogenital Diseases [C12]; Phenomena and Processes [G] - Metabolism [G03]
Gender: Male. Age: 18-64 years, 65+ years. Enrolment: 16.
Status: Ongoing, recruiting. Start date (EU): 2024-02-23. Decision date: 2023-08-30. Results received: No. Last updated: 2023-12-11.

Condition(s): Males aged ≥ 18 years with prostate cancer treated with abiraterone (arm 1) or not treated with abiraterone (arm 2). Patients with abiraterone treatment will take abiraterone 1000 mg per day.
Product: Oxycodon HCl Aurobindo 5 mg, capsules hard

Primary endpoint: Difference in the pharmacokinetics of oxycodone in patients with prostate cancer treated with abiraterone (arm 1) versus not treated with abiraterone, expressed in Cmax, AUC0-8h and t1/2.
Endpoint(s): The difference in pharmacokinetics of the metabolites of oxycodone in patients treated with abiraterone versus not treated with abiraterone, expressed in Cmax and AUC0-0-8h.

Source: https://euclinicaltrials.eu/ctis-public/view/2023-505705-17-00